EU clinical trial 2025-522093-36-00: C3651021: A PHASE 2b/3, RANDOMIZED, DOUBLE-BLIND STUDY TO INVESTIGATE THE EFFICACY, SAFETY, AND TOLERABILITY OF PONSEGROMAB (PF-06946860) COMPARED WITH PLACEBO BOTH WITH BACKGROUND FIRST-LINE CHEMOTHERAPY IN ADULT PARTICIPANTS WITH CACHEXIA AND METASTATIC PANCREATIC DUCTAL ADENOCARCINOMA
Protocol code: C3651021
Sponsor: Pfizer Inc. (Pharmaceutical company). Phase: Phase II and Phase III (Integrated). Countries: Slovakia (temporarily halted), Italy (temporarily halted), Belgium (temporarily halted), Germany (temporarily halted), Spain (temporarily halted), France (temporarily halted), Bulgaria (temporarily halted), Poland (temporarily halted).
Therapeutic area(s): Diseases [C] - Nutritional and Metabolic Diseases [C18]
Gender: Female, Male. Age: 18-64 years, 65+ years. Enrolment: 289.
Status: Temporarily halted. Start date (EU): 2026-05-20. Decision date: 2025-12-16. Results received: No. Last updated: 2026-06-29.
Decision dates by country: ES: 2025-12-22, BG: 2025-12-22, FR: 2025-12-22, IT: 2025-12-18, SK: 2025-12-16, DE: 2025-12-19, BE: 2025-12-16, PL: 2025-12-22

Condition(s): Cancer cachexia
Product: Ponsegromab (PF-06946860), Placebo to Ponsegromab (PF-06946860), CALCIUM LEVOFOLINATE PENTAHYDRATE

Primary endpoint: Percent change from baseline in body weight at Week 12., Change from baseline in FAACT-5IASS subscale scores at Week 12., Percent change from baseline body weight, in the open-label extension.
Endpoint(s): Change from baseline at Week 12 in physical activity as measured by time spent in non-sedentary activity, Overall survival, defined as the time from randomization to occurrence of all-cause death, Change from baseline in body weight (kg) at Week 12, Change from baseline at Week 12 in physical activity as measured by total vector magnitude, PFS, as determined by BICR assessment per RECIST 1.1, ORR, as determined by BICR assessment per RECIST 1.1, DCR, as determined by BICR assessment per RECIST 1.1, DOR, as determined by BICR assessment per RECIST 1.1, Change from baseline in body composition as measured by CT scan at Week 12 and and all other collected time points. CT (or MRI) based measures will include: •LSMI •Skeletal muscle area and radiodensity at third lumbar vertebra (L3) •Intermuscular adipose area and radiodensity at L3 •Subcutaneous adipose area and radiodensity at L3 •Visceral adipose area and radiodensity at L3, Incidence of: •TEAEs •SAEs •AEs leading to permanent discontinuation from study intervention or study •Clinical laboratory abnormalities •Vital Sign abnormalities •ECG abnormalities, Change from baseline at Week 12: •PROMIS®-Physical Function (version 8c, 7-day) •PROMIS®-Fatigue (version 7a), Change from baseline at all collected time points: •Body weight (and percent change) •FAACT Total and Sub-scale Scores (including FAACT-5IASS) •Time spent in non-sedentary activity • Total vector magnitude •PROMIS®-Physical Function (version 8c, 7-day) •PROMIS®-Fatigue (version 7a), Occurrence and severity of the symptomatic AEs including diarrhea, nausea, vomiting, decreased appetite, fatigue, and mouth sores by maximum grade as assessed by the NCI PRO CTCAE. •Overall side-effect impact as assessed by FACIT-GP5, Occurrence of chemotherapy dosing changes (including dose reductions, dosing interruptions, and permanent treatment discontinuations) due to occurrence of the AEs of nausea, vomiting, diarrhea, appetite decreased, or fatigue, Tumor status as determined by BICR assessment per RECIST 1.1 using CT scan (or MRI) at Week 12 and all other collected time points, Change from baseline at Week 12 and all other collected time points on ECOG PS, OLE: Incidence of: •TEAEs •SAEs •AEs leading to permanent discontinuation from study intervention or study •Clinical laboratory test abnormalities •Vital Sign abnormalities

Source: https://euclinicaltrials.eu/ctis-public/view/2025-522093-36-00